EU clinical trial 2024-514071-17-00: Temporal kinetics of antibody and cellular response markers and relative impact of revaccination in patients recovered from COVID-19 after treatment with monoclonal antibodies
Protocol code: Renoir
Sponsor: National Institute For Infectious Diseases Lazzaro Spallanzani (Hospital/Clinic/Other health care facility). Phase: Therapeutic use (Phase IV). Countries: Italy (authorised, recruitment pending).
Therapeutic area(s): Diseases [C] - Virus Diseases [C02]
Gender: Female, Male. Age: 18-64 years, 65+ years. Enrolment: 150.
Status: Authorised, recruitment pending. Decision date: 2024-07-31. Results received: No. Last updated: 2025-01-14.

Condition(s): Covid-19 infection
Product: Comirnaty 30 micrograms/dose dispersion for injection COVID-19 mRNA Vaccine, Spikevax 0.2 mg/mL dispersion for injection COVID-19 mRNA Vaccine, EVUSHELD 150 mg + 150 mg solution for injection, Xevudy 500 mg concentrate for solution for infusion, Nuvaxovid dispersion for injection COVID-19 Vaccine (recombinant, adjuvanted)

Primary endpoint: Evaluation of the effectiveness of revaccination at 4 versus 12 months on the temporal kinetics of humoral and cellular response markers.
Endpoint(s): 1) Evaluate the anti-N IgG antibody titer at 0, 1, 4, 6, 9, 12 months after the MAbs infusion 2) Evaluate the anti-S IgG antibody titer at 0, 1, 4, 6, 9, 12 months after the MAbs infusion 3) Evaluate the titer of neutralizing antibodies at 0, 1, 4, 6, 9, 12 months after the MAbs infusion 4) Evaluate cellular immunity to S and N with IGRA test at 0, 4, 12 months after MAbs infusion

Source: https://euclinicaltrials.eu/ctis-public/view/2024-514071-17-00